EU clinical trial 2024-516704-41-00: RANDOMIZED CONTROLLED CLINICAL TRIAL EVALUATING METHOTREXATE OR LEFLUNOMIDE + TARGETED THERAPY VERSUS METHOTREXATE OR LEFLUNOMIDE + SULFASALAZINE + HYDROXYCHLOROQUINE IN PATIENTS WITH RHEUMATOID ARTHRITIS AND INSUFFICIENT RESPONSE TO METHOTREXATE OR LEFLUNOMIDE (The BIO-3 trial)
Protocol code: 6020
Sponsor: Les Hopitaux Universitaires De Strasbourg (Hospital/Clinic/Other health care facility). Phase: Phase III and phase IV (Integrated). Countries: France (ongoing, recruiting).
Therapeutic area(s): Diseases [C] - Immune System Diseases [C20]
Gender: Female, Male. Age: 18-64 years, 65+ years. Enrolment: 270.
Status: Ongoing, recruiting. Start date (EU): 2016-03-30. Decision date: 2024-10-16. Results received: No. Last updated: 2025-02-14.

Condition(s): Rheumatoid Arthritis
Product: ETANERCEPT, TOCILIZUMAB, BARICITINIB, ABATACEPT, UPADACITINIB, METHOTREXATE, INFLIXIMAB, SARILUMAB, CERTOLIZUMAB PEGOL, GOLIMUMAB, METHOTREXATE, RITUXIMAB, METHOTREXATE, ADALIMUMAB, LEFLUNOMIDE, TOFACITINIB, SULFASALAZINE, FILGOTINIB, HYDROXYCHLOROQUINE SULFATE

Primary endpoint: Low disease activity (DAS28-CRP<3.2) and a daily dose ≤ 7.5 mg of equivalent prednisone under the randomized strategy after, at least, 11 months of follow up.
Endpoint(s): Serious adverse events rate, Blood concentrations of hydroxychloroquine, leflunomide, sulfasalazine and methotrexate in the triple therapy group and methotrexate, leflunomide, biologic / JAK/STAT inhibitor and anti-drug antibody in the other group at 6, and 12 months, Clinical disease activity index (CDAI) at inclusion, 3, 6, 9 and 12 months, DAS 28 CRP score at inclusion, 3, 6, 9 and12 months, 52010 ACR/EULAR classification Criteria for RA, ACR 20, 50, 70 and Boolean remission at 3, 6, 9 and 12 months, Modified Sharp Van der Hejde score at inclusion and at 12 month, Change in comedications (corticosteroids, dose of methotrexate or leflunomide, subcutaneous use of methotrexate), treatment observance, SF36 score, Rapid score, HAQ score, RAID score, FACIT score at inclusion, 3, 6, 9 and at 12 months, QUALISEX score at inclusion, 6 months and at 12 months, Medico-economic evaluation results at inclusion, 3, 6, 9 and at 12 months

Source: https://euclinicaltrials.eu/ctis-public/view/2024-516704-41-00